EU clinical trial 2025-521891-78-00: IMMUNOTIME « EVALUATION OF THE EFFECT OF TIME OF ADMINISTRATION ON THE ACTIVITY ON FIRST LINE OF PEMBROLIZUMAB IN ASSOCIATION WITH CARBOPLATIN PEMETREXED IN METASTATIC NON-SQUAMOUS LUNG CANCER. A RANDOMISED MULTICENTER PHASE III TRIAL»
Protocol code: APHP241011
Sponsor: Assistance Publique Hopitaux De Paris (Hospital/Clinic/Other health care facility). Phase: Therapeutic confirmatory (Phase III). Countries: France (authorised, recruitment pending).
Therapeutic area(s): Diseases [C] - Neoplasms [C04]
Gender: Female, Male. Age: 18-64 years, 65+ years. Enrolment: 254.
Status: Authorised, recruitment pending. Decision date: 2026-05-12. Results received: No. Last updated: 2026-05-28.

Condition(s): Adult patients with stage IV non squamous non-small cell lung cancer (NSCLC)
Product: PEMETREXED, CARBOPLATIN, KEYTRUDA 25 mg/mL concentrate for solution for infusion.

Primary endpoint: The main endpoint will be 1-year milestone survival rate, defined as the survival probability at one year
Endpoint(s): PFS defined as delay from randomisation until all-cause death or tumor progression whichever comes first., OS defined as delay from randomisation until all-cause death., Best tumor response rate according to RECIST criteria (assessed with TAP/brain scan and/or PET scan and/or MRI over 1 year)., Early response rate according to RECIST criteria (assessed with TAP/brain scan and/or PET scan and/or MRI) at the first evaluation (i.e. usually at 6 weeks)., Time to treatment discontinuation (TTD) as the delay from randomization until treatment stop irrespective of cause (progression, toxicities, loss of follow up, refusal, end of protocol or death)., Adverse events categorized by severity and type (grade 1, 2, 3, 4, or 5 according to CTCAE v5.0 criteria)., Self-assessment of quality of life measured using EQ-5D-5L and EORTC-QLQ C30 at baseline and every 4 courses up to 1 year (C4, C8, C12, C16)., Quality of sleep measured using Pittsburgh questionnaire and assessed at baseline and every 4 courses of treatment up to 1 year(C4, C8, C12, C16)., Chronotype measured using Horne-Ostberg questionnaire and assessed at baseline, and at courses 4 and 8 (C4 and C8)., Analysis of PFS/OS as a function of the real time of pembrolizumab infusion start, taken as a continuous variable, Incremental cost-utility ratio is calculated as Δ costs (between arms) / Δ QALYs (between arms)

Source: https://euclinicaltrials.eu/ctis-public/view/2025-521891-78-00